EU clinical trial 2024-514471-18-00: A Phase 3, Multicenter, Randomized, Double-Blind Study of the Efficacy and Safety of Rezafungin for Injection Versus the Standard Antimicrobial Regimen to Prevent Invasive Fungal Diseases in Adults Undergoing Allogeneic Blood and Marrow Transplantation (The ReSPECT Study)
Protocol code: CD101.IV.3.08
Sponsor: Mundipharma Research Limited (Pharmaceutical company). Phase: Therapeutic confirmatory (Phase III). Countries: France (ended), Italy (ended), Germany (ended), Belgium (ended), Spain (ended).
Therapeutic area(s): Diseases [C] - Bacterial Infections and Mycoses [C01]
Gender: Female, Male. Age: 18-64 years, 65+ years. Enrolment: 420.
Status: Ended. Start date (EU): 2020-05-13. End date (EU): 2025-12-18. End date: 2026-01-29. Decision date: 2024-06-27. Results received: No. Last updated: 2026-03-20.
Decision dates by country: DE: 2024-07-01, BE: 2024-06-27, IT: 2024-07-02, ES: 2024-06-27, FR: 2024-06-27

Condition(s): Invasive Fungal Diseases in Adults undergoing Allogeneic Blood and Marrow Transplantation (BMT)
Product: Diflucan 200mg Hard Capsules, PLACEBO to Posaconazol hexal, Posaconazol HEXAL 100 mg, NOXAFIL® (posaconazole) Injection, Placebo to bactrim, diflucan 200 mg - microcrystalline cellulose capsules, DIFLUCAN INJECTION, REZZAYO 200 mg powder for concentrate for solution for infusion, Saline solution, REZZAYO 200 mg powder for concentrate for solution for infusion, Bactrim Tablets, NOXAFIL® (posaconazole) Delayed-Release Tablets

Primary endpoint: The primary efficacy endpoint is fungal-free survival at Day 90 (±7 days), as defined by:, a) Survival, b) Absence of proven or probable IFD. Proven and probable IFD are defined per the modified 2020 European Organization for Research and Treatment of Cancer Mycoses Study Group Education and Research Consortium (EORTC-MSGERC) criteria (see Appendix 4 for complete IFD definitions), c) Absence of receipt of non-study drug systemic antifungal therapy (including anti-PCP drugs) for a cumulative exposure >10 days. Anti-PCP drugs include TMP-SMX, dapsone, atovaquone, pentamidine (IV or inhaled), and combined clindamycin and primaquine.
Endpoint(s): To evaluate secondary efficacy objectives, secondary efficacy endpoints include (a-e):, a) Study drug withdrawal due to toxicities or intolerance, b) Cumulative incidence of proven and probable IFD including numbers of invasive infection from Candida spp., Aspergillus spp., and Pneumocystis jirovecii, c) Time to IFD or death, defined as the number days from the first dose of study drug to the date of proven or probable IFD or death (all-cause). Subjects who do not have an event will be censored at the date last known to be IFD-free or alive. Subjects who are lost to follow-up will be censored at the date of last contact., d) All-cause mortality, e) Attributable mortality associated with IFD

Source: https://euclinicaltrials.eu/ctis-public/view/2024-514471-18-00